EU clinical trial 2024-519595-87-00: The Efficacy and Safety of Bimatoprost SR in Patients With Open-angle Glaucoma or Ocular Hypertension
Protocol code: 192024-092
Sponsor: AbbVie Deutschland GmbH & Co. KG (Pharmaceutical company). Phase: Therapeutic confirmatory (Phase III). Countries: Germany (ended).
Therapeutic area(s): Diseases [C] - Eye Diseases [C11]
Gender: Female, Male. Age: 18-64 years, 65+ years. Enrolment: 3.
Status: Ended. Start date (EU): 2015-12-15. End date (EU): 2026-07-16. End date: 2026-07-17. Decision date: 2024-12-18. Results received: No. Last updated: 2025-06-04.

Condition(s): Ocular hypertension, Open-angle glaucoma
Product: Timolol vehicle, Bimatoprost SR sham applicator, Timolol, Bimatoprost SR, Bimatoprost SR

Primary endpoint: Study eye time-matched IOP change from baseline (follow-up minus time-matched baseline) at each hour evaluated (Hours 0 and 2).
Endpoint(s): Time-matched IOP

Source: https://euclinicaltrials.eu/ctis-public/view/2024-519595-87-00